EU clinical trial 2023-506516-40-00: A Phase III Multicenter, Randomized, Double-Blind, Double-Dummy Study to Evaluate Safety and Efficacy of Ocrelizumab in Comparison with Fingolimod in Children and Adolescents with Relapsing-Remitting Multiple Sclerosis
Protocol code: WN42086
Sponsor: F. Hoffmann-La Roche AG (Pharmaceutical company). Phase: Therapeutic confirmatory (Phase III). Countries: Belgium (ongoing, recruitment ended), Romania (ongoing, recruitment ended), Poland (ongoing, recruitment ended), Portugal (ongoing, recruitment ended), Netherlands (ended), Denmark (ended), Estonia (ongoing, recruitment ended), Austria (ongoing, recruitment ended), Croatia (ended), Hungary (ongoing, recruitment ended), Italy (ongoing, recruitment ended), France (ongoing, recruitment ended), Greece (ongoing, recruitment ended), Bulgaria (ended), Spain (ongoing, recruitment ended), Latvia (ongoing, recruitment ended), Germany (ongoing, recruitment ended).
Therapeutic area(s): Diseases [C] - Nervous System Diseases [C10]
Gender: Female, Male. Age: 0-17 years. Enrolment: 94.
Start date (EU): 2022-02-11. Decision date: 2024-02-07. Results received: No. Last updated: 2026-07-28.
Decision dates by country: NL: 2024-02-08, BG: 2024-03-18, DK: 2024-02-07, HR: 2024-02-08, DE: 2024-02-09, EE: 2024-02-12, HU: 2024-02-08, LV: 2024-02-07, AT: 2024-03-25, PL: 2024-02-20, RO: 2024-02-12, BE: 2024-02-14, ES: 2024-02-08, PT: 2024-02-07, IT: 2024-02-12, GR: 2024-03-22, FR: 2024-02-16

Condition(s): Relapsing-Remitting Multiple Sclerosis
Product: Gilenya 0.5 mg hard capsules, Gilenya 0.25 mg hard capsules, Methylprednisolon acis 1000 mg Pulver und Lösungsmittel zur Herstellung einer Injektions- bzw. Infusionslösung, Methylprednisolon acis 250 mg Pulver und Lösungsmittel zur Herstellung einer Injektions- bzw. Infusionslösung, Placebo for FINGOLIMOD, Gilenya 0.25 mg hard capsules, Ocrevus 300 mg concentrate for solution for infusion, Gilenya 0.25 mg hard capsules, Reisetabletten AL Dimenhydrinat 50 mg pro Tablette, Placebo for Ocrelizumab

Primary endpoint: 1. Protocol-defined annualized relapse rate (ARR) (non-inferiority)
Endpoint(s): 1. Number of new or enlarging T2 lesions as detected by brain MRI during the double-blind period, 2. Number of T1 gadolinium (Gd) lesions at Week 12, 3. Protocol-defined ARR during the double-blind period (superiority), 4. Incidence and severity of adverse events, with severity determined according to National Cancer Institute Common Terminology Criteria for Adverse Events, Version 5.0 (NCI CTCAE v5.0), 5. Change from baseline in targeted vital signs and clinical significant abnormalities in electrocardiogram (ECG) parameters, 6. Change from baseline in targeted clinical laboratory test results, 7. Concentrations of ocrelizumab at indicated time points, 8. Levels of CD19 B-cell count in blood, 9. Prevalence of anti-drug antibodies (ADAs) against ocrelizumab at baseline, 10. Incidence of ADAs against ocrelizumab during the study

Source: https://euclinicaltrials.eu/ctis-public/view/2023-506516-40-00